EU clinical trial 2024-514144-85-02: Phase I/IIa study of concomitant radiotherapy with olaparib and temozolomide in unresectable high grade gliomas patients
Protocol code: OLA-TMZ-RTE-01
Sponsor: Centre Francois Baclesse (Hospital/Clinic/Other health care facility). Phase: Human Pharmacology (Phase I)- Other. Countries: France (authorised, recruitment pending).
Therapeutic area(s): Diseases [C] - Neoplasms [C04]
Gender: Female, Male. Age: 18-64 years, 65+ years. Enrolment: 91.
Status: Authorised, recruitment pending. Decision date: 2024-11-08. Results received: No. Last updated: 2026-04-20.

Condition(s): Glioblastoma

Source: https://euclinicaltrials.eu/ctis-public/view/2024-514144-85-02